EU clinical trial 2025-523522-41-00: C6461004 - A GLOBAL PHASE 2/3 INTERVENTIONAL STUDY OF PF-08634404 IN COMBINATION WITH CHEMOTHERAPY IN PARTICIPANTS WITH EXTENSIVE-STAGE SMALL CELL LUNG CANCER
Protocol code: C6461004
Sponsor: Pfizer Inc. (Pharmaceutical company). Phase: Phase II and Phase III (Integrated). Countries: France (authorised, recruitment pending), Italy (authorised, recruitment pending), Germany (authorised, recruitment pending), Spain (ongoing, recruiting).
Therapeutic area(s): Diseases [C] - Neoplasms [C04]
Gender: Female, Male. Age: 18-64 years, 65+ years. Enrolment: 182.
Start date (EU): 2026-06-30. Decision date: 2026-04-07. Results received: No. Last updated: 2026-04-10.
Decision dates by country: FR: 2026-04-07, DE: 2026-04-10, IT: 2026-04-09, ES: 2026-04-09

Condition(s): Extensive-Stage Small Cell Lung Cancer
Product: ETOPOSIDE, ATEZOLIZUMAB, PF-08634404, CARBOPLATIN

Primary endpoint: Phase 2: • Confirmed ORR as assessed by investigator based on RECIST v1.1 • AEs as characterized by type, frequency, severity (as graded by NCI CTCAE version 5.0), timing, seriousness, and relationship to study intervention., Phase 3: • OS
Endpoint(s): Phase 2 • DOR as assessed by investigator based on RECIST v1.1 • PFS as assessed by investigator based on RECIST v1.1 • OS, Phase 2 • Laboratory abnormalities as characterized by type, frequency, severity (as graded by NCI CTCAE version 5.0), and timing. • DLTs, Phase 2 • Predose and postdose concentrations of PF 08634404., Phase 2 • Incidence of ADA against PF-08634404., Phase 3 • PFS using RECIST v1.1 as assessed by BICR, Phase 3 • Confirmed ORR using RECIST v1.1 as assessed by BICR • Confirmed ORR using RECIST v1.1 as assessed by investigator, Phase 3 • PFS using RECIST v1.1 as assessed by investigator, Phase 3 • DOR using RECIST v1.1 as assessed by BICR • DOR using RECIST v1.1 as assessed by investigator, Phase 3 • AEs as characterized by type, frequency, intensity as graded by NCI CTCAE version 5.0, timing, seriousness, and relationship to study intervention(s)., Phase 3 • Laboratory test abnormalities as characterized by type, frequency, severity (as graded by NCI CTCAE version 5.0) and timing., Phase 3 • Predose and postdose concentrations of PF 08634404., Phase 3 • Incidence of ADA against PF 08634404., Phase 3 • Mean scores and change from baseline in the global health status/QoL, function, and symptom scores on the EORTC QLQ-C30 • Mean scores and change from baseline on the EORTC QLQ-LC13 • Time to definitive deterioration in the global health status/QoL, function, and symptom scores on the EORTC QLQ-C30 • Time to definitive deterioration in dyspnea, cough, or chest pain on the EORTC QLQ-LC13

Source: https://euclinicaltrials.eu/ctis-public/view/2025-523522-41-00